EU clinical trial 2022-503142-41-00: An Extension Study of JR-141 to Evaluate the Long-term Safety and Efficacy in Mucopolysaccharidosis Type II (Hunter Syndrome) Subjects
Protocol code: JR-141-GS32
Sponsor: Jcr Pharmaceuticals Co. Ltd. (Pharmaceutical company). Phase: Therapeutic confirmatory (Phase III). Countries: France (ongoing, recruiting), Spain (ongoing, recruiting), Germany (ongoing, recruiting), Poland (ongoing, recruiting), Italy (ongoing, recruiting).
Therapeutic area(s): Diseases [C] - Congenital, Hereditary, and Neonatal Diseases and Abnormalities [C16]
Gender: Female, Male. Age: 0-17 years, 18-64 years, 65+ years. Enrolment: 32.
Status: Ongoing, recruiting. Start date (EU): 2024-05-06. Decision date: 2024-03-25. Results received: No. Last updated: 2026-05-29.
Decision dates by country: IT: 2024-07-31, ES: 2024-03-25, PL: 2024-04-02, FR: 2024-04-16, DE: 2024-04-03

Condition(s): Mucopolysaccharidosis type II, Hunter Syndrome
Product: JR-141

Primary endpoint: CSF HS (Total HS and HS disaccharide), dermatan sulfate (DS), and neurofilament light chain (NfL) concentrations, and opening pressure, Neuropsychological assessment, Others: Time course of QoL assessment, sleep disturbance, and global impression in Cohort A and Cohort B, Time course of Toileting Abilities Survey (TAS) in Cohort A and Cohort B
Endpoint(s): Liver and spleen volume, Shoulder range of motion, Six-minute walk test, Serum HS (Total), DS, and NfL concentrations, Urinary HS (Total) and DS concentrations, Pulmonary function (Cohort B only, if deemed feasible by principal investigator), Others: Time course of cardiac function (LVMI, IVST, and PWT) in Cohort A and Cohort B, Time course of T.O.V.A.® in Cohort B, Safety endpoints (Cohort A and Cohort B): Continuous assessment of AEs, including IARs, Periodical assessment of laboratory tests (hematology, blood biochemistry, iron-related tests, and urinalysis); vital signs (pulse rate, body temperature, respiratory rate, blood pressure); 12-lead ECG; anti-JR-141 antibodies, physical and neurological examination, weight, and height

Source: https://euclinicaltrials.eu/ctis-public/view/2022-503142-41-00